EU clinical trial 2024-519884-16-00: Ultimate dePletion of autoReactive b cells using Obinutuzumab from sjÖgren's syndrome affected Tissues study- UPROOT study
Sponsor: Radboud universitair medisch centrum Stichting (Hospital/Clinic/Other health care facility). Phase: Therapeutic exploratory (Phase II). Countries: Netherlands (authorised, recruitment pending).
Therapeutic area(s): Diseases [C] - Immune System Diseases [C20]
Gender: Female, Male. Age: 18-64 years, 65+ years. Enrolment: 10.
Status: Authorised, recruitment pending. Decision date: 2026-03-11. Results received: No. Last updated: 2026-04-21.

Condition(s): Sjögren's syndrome
Product: Gazyvaro 1,000 mg concentrate for solution for infusion.

Primary endpoint: Depletion of anti-Ro60, anti-Ro52, anti-La and rheumatoid factor B cells in blood, inflamed salivary gland and involved lymph node of patients with SjS at 3 months after initiation of Obinutuzumab compared to sampling before treatment initiation.
Endpoint(s): - Change from baseline in ESSDAI score at Week 12, 24 and 36 (11)., - Proportion of patients achieving ≥3 points reduction from baseline in ESSDAIscore at Week 12, 24 and 36., - Proportion of patients achieving ESSDAI<5 at Week 12, 24 and 36., - Change from baseline in PhGA of disease activity at Week 12, 24 and 36, - Change from baseline in PaGA of disease activity at Week 12, 24 and 36., - Proportion of patients achieving ≥ 1 point or 15% reduction from baseline in ESSPRI at Week 12, 24 and 36 (11)., 1. Change from baseline in STAR, Schirmer’s test, unstimulated whole saliva secretion

Source: https://euclinicaltrials.eu/ctis-public/view/2024-519884-16-00